EU clinical trial 2023-509951-15-00: A study in healthy people to compare how 2 different low dose formulations of BI 1015550 are taken up in the body
Protocol code: 1305-0051
Sponsor: Boehringer Ingelheim International GmbH (Pharmaceutical company). Phase: Human Pharmacology (Phase I)- Bioequivalence Study. Countries: Germany (ended).
Therapeutic area(s): Not possible to specify
Gender: Female, Male. Age: 18-64 years. Enrolment: 64.
Status: Ended. Start date (EU): 2024-06-06. End date (EU): 2024-08-28. Decision date: 2024-06-05. Results received: No. Last updated: 2024-07-30.

Condition(s): Pharmacokinetic trial

Source: https://euclinicaltrials.eu/ctis-public/view/2023-509951-15-00